EU clinical trial 2024-518940-19-02: Pentaglobin as early adjuvant treatment for febrile neutropenia in acute leukemia or allogeneic hematopoietic stem cell transplant patients colonized by carbapenem-resistant Enterobacteriaceae or Pseudomonas aeruginosa
Sponsor: Gruppo Italiano Per Il Trapianto Di Midollo Osseo Cellule Staminali Emopoietiche E Terapia Cellulare (Patient organisation/association). Phase: Therapeutic exploratory (Phase II). Countries: Italy (ongoing, recruitment ended).
Therapeutic area(s): Diseases [C] - Hemic and Lymphatic Diseases [C15]
Gender: Female, Male. Age: 18-64 years, 65+ years. Enrolment: 120.
Status: Ongoing, recruitment ended. Start date (EU): 2025-01-28. Decision date: 2025-01-28. Results received: No. Last updated: 2025-09-17.

Condition(s): Acute Myeloid Leukemia (AML)
Product: Pentaglobin 50 mg/ml soluzione per infusione

Primary endpoint: This study will have two co-primary endpoints: • To demonstrate a 50% reduction in 30-day mortality for carriers developing a pre-engraftment bloodstream infection sustained by carbapenem-resistant Enterobacteriaceae (CRE) or Pseudomonas aeruginosa (PA) (earlier primary endpoint). To increase by 20% the Overall Survival (OS) at 4 months from the start of intensive treatment in all carriers of CRE or PA compared to historical controls (later primary endpoint).
Endpoint(s): OS in CRE or PA carriers not developing a bloodstream infection sustained the colonizing agent at 4 months from the start of intensive chemotherapy or transplant; Days of fever > 38.3°C at 30 days from the day of start intensive chemotherapy or from day of transplant. Days of hospitalization at 30 days from the start of intensive chemotherapy or from day of transplant; Days of i.v. antimicrobials at 30 days from the start of intensive chemotherapy or from day of transplant., Non-relapse mortality (NRM) at 4 months from the start of intensive chemotherapy or transplant; Incidence and severity of adverse drug reactions (ADR) classified by System Organ Class (SOC) and preferred term (PT) at 30 days from start treatment with Pentaglobin; Incidence and severity of acute GvHD at 120 days from day of transplant. Incidence and severity of chronic GvHD at 1 year day of transplant., The cumulative incidence of graft failure / time to neutrophil and platelet recovery at 30 and 60 days from the day of start intensive chemotherapy or from day of transplant. One year probability of GRFS (GvHD free, relapse free survival) from the day of start intensive chemotherapy or from day of transplant.

Source: https://euclinicaltrials.eu/ctis-public/view/2024-518940-19-02